EU clinical trial 2025-524002-16-00: A Phase 3, Randomized, Double-blind, Placebo-controlled Study to Evaluate the Efficacy and Safety of Pridopidine in Participants with Amyotrophic Lateral Sclerosis
Protocol code: PL101-ALS301
Sponsor: Ferrer Internacional S.A., Prilenia Therapeutics B.V. (Pharmaceutical company). Phase: Therapeutic confirmatory (Phase III). Countries: Belgium (ongoing, recruiting), Netherlands (ongoing, recruiting), Poland (ongoing, recruiting), France (ongoing, recruiting), Germany (ongoing, recruiting), Ireland (authorised, recruiting), Italy (ongoing, recruiting), Sweden (ongoing, recruiting), Spain (ongoing, recruiting).
Therapeutic area(s): Diseases [C] - Nervous System Diseases [C10]
Gender: Female, Male. Age: 18-64 years, 65+ years. Enrolment: 420.
Start date (EU): 2026-05-12. Decision date: 2026-04-20. Results received: No. Last updated: 2026-05-14.
Decision dates by country: BE: 2026-04-27, FR: 2026-04-24, DE: 2026-04-23, IE: 2026-04-24, IT: 2026-04-20, ES: 2026-04-22, SE: 2026-04-20, NL: 2026-04-20, PL: 2026-04-23

Condition(s): Amyotrophic Lateral Sclerosis
Product: PRIDOPIDINE, Pridopidine placebo

Primary endpoint: Change from baseline through Week 26 in the ALSFRS-R total score adjusted for mortality. Change from baseline through Week 48 in the ALSFRS-R total score adjusted for mortality.
Endpoint(s): Overall survival at Week 96, Change from baseline through Week 26, Week 48 in Speaking rate as measured by quantitative speech assessment in the clinic. Change from baseline through Week 48 in Intelligibility of speech as measured by quantitative speech assessment in the clinic., Change from baseline through Week 48 in percent predicted slow vital capacity, Change from baseline through Week 48 in the Bulbar subdomain of the ALSFRS-R, Change from baseline through Week 48 in the ALSAQ-40, Incidence, nature, and severity of treatment emergent adverse events, adverse events of special interest, and serious adverse events. Incidence and shifts of clinically significant abnormalities in ECG, laboratory tests, and vital signs. Change from baseline in C-SSRS. Tolerability.

Source: https://euclinicaltrials.eu/ctis-public/view/2025-524002-16-00